EU clinical trial 2024-519669-23-00: Regorafenib as second-line treatment of patients with RAS-mutant advanced colorectal cancer: a multicentre, phase 2 study - STREAM-2
Sponsor: IRCCS Istituto Nazionale Tumori Fondazione Pascale (Hospital/Clinic/Other health care facility). Phase: Therapeutic exploratory (Phase II). Countries: Italy (ongoing, recruiting).
Therapeutic area(s): Diseases [C] - Neoplasms [C04]
Gender: Female, Male. Age: 18-64 years, 65+ years. Enrolment: 60.
Status: Ongoing, recruiting. Start date (EU): 2025-09-29. Decision date: 2025-06-05. Results received: No. Last updated: 2025-10-02.

Condition(s): Patients with metastatic colorectal cancer (mCRC) RAS-mutant
Product: Calcio levofolinato Teva Generics 175 mg polvere per soluzione per infusione, BEVACIZUMAB, ZALTRAP 25 mg/ml concentrate for solution for infusion, Oxaliplatin 5 mg/ml concentrate for solution for infusion, Stivarga 40 mg film-coated tablets, FLUOROURACIL, FLUOROURACIL, Irinotecan Accord 20 mg/ml concentrato per soluzione per infusione, CAPECITABINE

Primary endpoint: Progression Free Survival rate at 6 months in the two arms. Progression Free Survival rate at 6 months(PFS rate at 6-months) is defined as the rate of assessable patients alive and not progressed after 6 months from study initiation (i.e randomization) to the first documentation of objective disease progression by RECIST 1.1 criteria, or death due to any cause, whichever occurs first.
Endpoint(s): Progression free survival (PFS) calculated as the time from randomization until the date of death from any cause until the date of the first observation of disease progression or death due to any cause, whichever occurs first. PFS will be censored at the time of the last available tumor assessment documenting absence of progressive disease for patients alive at the time of analysis., Overall survival (OS) calculated as the time from randomization until the date of death from any cause. OS will be censored at the last date the patient was known to be alive for patients alive at the time of analysis, Objective Tumor Response Rate (ORR) assessed according to RECIST criteria 1.1, as the proportion of patients achieving complete or partial response relative to total enrolled patients., Disease Control Rate (DCR) defined as the proportion of patients with complete/partial response and stable disease as their best response., Progression free survival 2 (PFS2) calculated as the time from registration to progression from subsequent line of treatment or death without progression, whichever occurred first., Overall Toxicity rate defined as adverse events graded according NCI CTCAE v 5.0. as the proportion of patients experiencing any grade AE accordingly to the NCI Common Terminology Criteria of Adverse Events (NCI CTC-AE) Version 5, relative to the total of patients receiving at least one cycle of treatment.AE will be listed individually by the patient and summarized overall (severity grades 1-4) and for grade ≥3 by treatment received., Quality of life (QoL) investigated through the EORTC QOL-C30 and CR29 questionnaires at baseline (prior to treatment start, once eligibility is confirmed) and every 8 weeks from randomization until disease progression, treatment failure or death., PRO-CTCAE questionnaires will be administered at the same time points with items dedicated in particular to Hand-Foot Syndrome and Hand-Foot skin reactions, diarrhea and neuropathy, to better evaluate the effect of two different strategies of treatment on the health-related QoL., Time/toxicity defined as time spent coordinating treatments and in-visits to a health care facility (including travel and waiting), seeking urgent/emergent care for side effects, hospitalizations, and follow-up tests and rehabilitation (measured as Days with Physical Health Care System Contact, Financial toxicity assessed through the PROFFIT questionnaire at baseline (prior to treatment start, once eligibility is confirmed) and every 8 weeks from randomization until disease progression, treatment failure or death.

Source: https://euclinicaltrials.eu/ctis-public/view/2024-519669-23-00